EU clinical trial 2022-502527-21-00: Phase 1/2 Study of BLU-451 in Advanced Cancers with EGFR exon20 Insertion Mutations
Protocol code: BLU-451-1101
Sponsor: Blueprint Medicines Corp. (Pharmaceutical company). Phase: Phase I and Phase II (Integrated)- First administration to humans. Countries: Spain (authorised, recruitment pending).
Therapeutic area(s): Diseases [C] - Neoplasms [C04]
Gender: Female, Male. Age: 18-64 years, 65+ years. Enrolment: 28.
Status: Authorised, recruitment pending. Decision date: 2023-10-10. Results received: No. Last updated: 2023-10-10.

Condition(s): Advanced cancers with EGFR Exon20 insertions mutations
Product: BLU-451, BLU-451, BLU-451

Primary endpoint: 1. (Phase 1). Maximum tolerated dose (MTD) determination: Dose-limiting toxicity (DLT) rate, 2. (Phase 1). Recommended Phase 2 dose (RP2D) determination: DLT, PK, PD, and preliminary safety data, 3. (Phase 1). Overall safety profile as assessed by the type, frequency, severity, timing, and relationship to study drug of adverse events (AEs), and changes in vital signs, electrocardiograms, and safety laboratory tests, 4. (Phase 2). Objective Response Rate (ORR)
Endpoint(s): 1. (Phase 1). Plasma concentrations of BLU-451 as a function of time post-dosing. C3PK parameters for single (first) dose and multiple doses, 2. (Phase 1). • ORR • DOR • Disease control rate (DCR) • Clinical benefit rate (CBR) • PFS • OS, 3. (Phase 1). • CNS ORR • CNS DOR • CNS PFS, 4. (Phase 1). Profile pharmacodynamic changes in gene expression levels of the EGFR pathway biomarkers dual specificity phosphatase (DUSP6) and sprouty RTK signaling antagonist 4 (SPRY4), 5. (Phase 2). Safety profile as assessed by the type, frequency, severity, timing, and relationship to study drug of adverse events (AEs), and changes in vital signs, electrocardiograms, and safety laboratory tests, 6. (Phase 2). • DOR • DCR • CBR • PFS • OS, 7. (Phase 2). • CNS ORR • CNS DOR • CNS PFS, 8. (Phase 2). • Plasma concentrations of BLU-451 as a function of time post-dosing • PK parameters for single (first) dose and multiple doses

Source: https://euclinicaltrials.eu/ctis-public/view/2022-502527-21-00